EU clinical trial 2024-514032-25-00: A MULTICENTER, SEEKING SIGNAL, RANDOMISED, OPEN-LABEL PHASE II OF RELATLIMAB AND NIVOLUMAB VS NIVOLUMAB ALONE IN LOCALLY ADVANCED CERVICAL CANCERS
Protocol code: GINECO- CE111b
Sponsor: Asso De Recherche Cancers Gynecologiques (Laboratory/Research/Testing facility). Phase: Therapeutic exploratory (Phase II). Countries: France (ongoing, recruitment ended).
Therapeutic area(s): Diseases [C] - Neoplasms [C04]
Gender: Female. Age: 18-64 years, 65+ years. Enrolment: 72.
Status: Ongoing, recruitment ended. Start date (EU): 2024-12-11. Decision date: 2024-09-24. Results received: No. Last updated: 2026-07-24.

Condition(s): Patients with a histilogically confirmed diagnosis of cervical squamous or adenosquamous carcinoma stage IB3 if N>=1 or II to IVA with any N stage according to FIGO 2018 and no evidence of metastatic disease (M0), without any prior anti-cancer treatment.

Source: https://euclinicaltrials.eu/ctis-public/view/2024-514032-25-00